EU clinical trial 2023-504734-21-00: A Phase 3b, Multicenter, Randomized, Double-blind, Placebo-controlled Study Evaluating the Efficacy and Safety of Subcutaneously Administered Guselkumab in Improving the Signs and Symptoms and Inhibiting Radiographic Progression in Participants with Active Psoriatic Arthritis.
Protocol code: CNTO1959PSA3004
Sponsor: Janssen - Cilag International (Pharmaceutical company). Phase: Therapeutic confirmatory (Phase III). Countries: Czechia (ongoing, recruitment ended), Slovakia (ongoing, recruitment ended), Croatia (ongoing, recruitment ended), Latvia (ongoing, recruitment ended), Hungary (ongoing, recruitment ended), Lithuania (ongoing, recruitment ended), Italy (ongoing, recruitment ended), Estonia (ongoing, recruitment ended), Bulgaria (ongoing, recruitment ended), Poland (ended), Spain (ongoing, recruitment ended), Slovenia (ongoing, recruitment ended), Germany (ongoing, recruitment ended), Greece (ongoing, recruitment ended).
Therapeutic area(s): Diseases [C] - Immune System Diseases [C20]
Gender: Female, Male. Age: 18-64 years, 65+ years. Enrolment: 421.
Start date (EU): 2021-08-30. Decision date: 2024-07-24. Results received: No. Last updated: 2026-08-06.
Decision dates by country: SK: 2024-07-26, PL: 2024-08-04, EE: 2024-07-25, BG: 2024-07-29, HR: 2024-07-26, SI: 2024-08-01, CZ: 2024-07-25, DE: 2024-08-01, GR: 2024-10-11, HU: 2024-07-25, IT: 2024-08-07, LV: 2024-08-06, LT: 2024-08-07, ES: 2024-07-24

Condition(s): Psoriatic arthritis (PsA)
Product: Guselkumab - solution for injection in pre-filled syringe - 100 mg/mL, Placebo to Guselkumab Solution for injection in pre-filled syringe 100 mg/ml.

Primary endpoint: Proportion of participants with American College of Rheumatology (ACR) 20 response at Week 24.

Source: https://euclinicaltrials.eu/ctis-public/view/2023-504734-21-00